EU clinical trial 2024-514043-29-00: DFIL2-REP - Study of the clinical and biological response to repeated administration of low-dose interleukin-2 in patients with type 1 diabetes who have retained residual insulin secretion
Protocol code: P120142
Sponsor: Assistance Publique Hopitaux De Paris (Hospital/Clinic/Other health care facility). Phase: Therapeutic exploratory (Phase II). Countries: France (ongoing, recruitment ended).
Therapeutic area(s): Diseases [C] - Immune System Diseases [C20]
Gender: Female, Male. Age: 18-64 years. Enrolment: 24.
Status: Ongoing, recruitment ended. Start date (EU): 2022-09-21. Decision date: 2024-07-19. Results received: No. Last updated: 2026-06-18.

Condition(s): Patient with newly diagnosed (≤ 3 months) type 1 diabetes stage 3
Product: CICLOSPORIN, Placebo of ILT-101, ILT-101 liquide

Primary endpoint: Variation in Tregs values at D70 compared with post-ciclosporin values (D63)
Endpoint(s): Compliance with ciclosporin and ILT-101/placebo, Tolerance: tolerance will be assessed from D1 to D719 by means of a clinical examination, measurement of vital signs, a systematic biological check-up and collection of adverse events at every visit., Evolution of residual insulin secretion, Change in Tregs values at M3 (J88), M6 (J179), M9 (J270), M12 (J361) and after treatment discontinuation at M18 (J536) and M24 (J719) compared to baseline and post-ciclosporin values (J63)

Source: https://euclinicaltrials.eu/ctis-public/view/2024-514043-29-00